EU clinical trial 2025-522713-29-00: A Phase 3 Randomized, Open-label Study of Pasritamig (JNJ-78278343), a T-cell-redirecting Agent Targeting Human Kallikrein 2, With Docetaxel Versus Docetaxel for Metastatic Castration-resistant Prostate Cancer
Protocol code: 78278343PCR3003
Sponsor: Janssen Cilag International (Pharmaceutical company). Phase: Therapeutic confirmatory (Phase III). Countries: Belgium (ongoing, recruiting), Italy (ongoing, recruiting), Spain (ongoing, recruiting), Germany (ongoing, recruiting), France (ongoing, recruiting).
Therapeutic area(s): Diseases [C] - Neoplasms [C04]
Gender: Male. Age: 18-64 years, 65+ years. Enrolment: 171.
Status: Ongoing, recruiting. Start date (EU): 2026-03-12. Decision date: 2026-03-09. Results received: No. Last updated: 2026-04-30.
Decision dates by country: BE: 2026-03-10, FR: 2026-03-23, DE: 2026-03-12, IT: 2026-03-09, ES: 2026-03-12

Condition(s): Metastatic Castration-resistant Prostate Cancer (mCRPC)
Product: JNJ-78278343, Docetaxel AqVida 20 mg/ml Konzentrat zur Herstellung einer Infusionslösung, JNJ-78278343, Prednison acis 5 mg, Tabletten, DOCETAXEL, PREDNISONE

Primary endpoint: rPFS, measured as the time from randomization to the time of radiographic disease progression per PCWG3 and RECIST v1.1 as assessed by BICR on CT/MRI or bone scan, or death from any cause, whichever occurs first.

Source: https://euclinicaltrials.eu/ctis-public/view/2025-522713-29-00